EU clinical trial 2023-503530-41-00: Melatonin for Chronic back pain (The MOCHA trial)
Protocol code: 23.002
Sponsor: Odense University Hospital (Hospital/Clinic/Other health care facility). Phase: Therapeutic confirmatory (Phase III). Countries: Denmark (ended).
Therapeutic area(s): Diseases [C] - Musculoskeletal Diseases [C05]
Gender: Female, Male. Age: 18-64 years. Enrolment: 220.
Status: Ended. Start date (EU): 2024-11-07. End date (EU): 2026-04-13. Decision date: 2024-03-14. Results received: No. Last updated: 2024-11-18.

Condition(s): Chronic back pain
Product: Melatonin "AGB", tabletter, Placebo tablet identical with melatonin AGB 5 mg tablet in appearance. Unauthorised product

Primary endpoint: Average back pain intensity during the past 7 days. Difference in change between treatment groups (Melatonin vs. placebo) from baseline to 6 weeks. Average pain intensity during past 7 days will be assessed on a 0-10 Numeric Rating Scale (NRS) (ranging from ‘no pain to ‘worst imaginable pain’).
Endpoint(s): Trajectory of weekly (at 0, 1, 2, 3, 4, 5 and 6 weeks) NRS back pain intensity scores (primary outcome) from baseline to 6 weeks., Number of patients with more than 30% improvement in the primary outcome from baseline to 6 weeks (Number of responders are calculated for both the Melatonin and the placebo group)., Number of patients with more than 50% improvement in the primary outcome from baseline to 6 weeks (Number of responders are calculated for both the Melatonin and the placebo group)., Back pain related disability. Difference in change between treatment groups (Melatonin vs. placebo) from baseline to 6 weeks. Back pain related disability will be assessed using the Roland Morris Disability Questionnaire (RMQ)., Global Perceived Effect (GPE). Assessment of overall change in back pain from baseline to 6 weeks. Participants will be asked at 6 weeks: ‘How is your back pain now compared to when you entered this study’, with 5 response options (much worse, worse, almost the same/unchanged, improved, much improved).25, Physical and mental health will be assessed using the Patient-Reported Outcomes Measurement Information System (PROMIS-10) Global Health questionnaire version 1.2.26 Difference in change in physical and mental health scores between treatment groups (Melatonin vs. placebo) from baseline to 6 weeks. PROMIS-10 consist of 10 questions concerning different aspects of global health. The first 9 questions are score on a Likert scale with 5 response options, and the last question is asking about pain, Insomnia symptoms. Difference in change between treatment groups (Melatonin vs. placebo) from baseline to 6 weeks. Insomnia will be assessed with the Insomnia Severity Index (ISI), which is a brief 7 item patient-reported instrument with a score ranging from 0-28 (0=best;28=worst), insomnia will be defined according to described cut-offs., Pain sensitivity (i.e. pressure pain threshold). Difference in change between treatment groups (Melatonin vs. placebo) from baseline to 6 weeks. Pressure pain threshold is assessed using a handheld algometer. Pressure pain thresholds will be assessed locally at the right erector spinae muscle (3 cm from the fourth lumbar spinous process) and at the left upper trapezius muscle (10 cm horizontally from the acromion in direct line with the seventh cervical spinous process).

Source: https://euclinicaltrials.eu/ctis-public/view/2023-503530-41-00